EU clinical trial 2022-502622-40-00: A Phase 1 study to evaluate IK-930 in subjects with advanced solid tumors
Protocol code: IK930-001
Sponsor: Ikena Oncology Inc. (Pharmaceutical company). Phase: Human Pharmacology (Phase I)- First administration to humans. Countries: Netherlands (ended), France (ended), Spain (ended), Italy (ended).
Therapeutic area(s): Diseases [C] - Neoplasms [C04]
Gender: Female, Male. Age: 18-64 years, 65+ years. Enrolment: 31.
Status: Ended. End date (EU): 2024-05-28. End date: 2024-08-27. Decision date: 2024-05-14. Results received: No. Last updated: 2024-05-23.
Decision dates by country: FR: 2024-05-14, IT: 2024-05-20, NL: 2024-05-21, ES: 2024-05-23

Condition(s): Advanced Solid Tumors

Source: https://euclinicaltrials.eu/ctis-public/view/2022-502622-40-00